EU clinical trial 2024-519445-29-00: Dose Escalation and Dose Expansion Study of BBO-10203 in Subjects with Advanced Solid Tumors
Protocol code: TBBO10203-101
Sponsor: Theras Inc. (Pharmaceutical company). Phase: Human Pharmacology (Phase I)- First administration to humans. Countries: Spain (ongoing, recruiting), France (ongoing, recruiting), Italy (ended).
Therapeutic area(s): Diseases [C] - Neoplasms [C04]
Gender: Female, Male. Age: 18-64 years, 65+ years. Enrolment: 91.
Start date (EU): 2025-10-02. Decision date: 2025-04-04. Results received: No. Last updated: 2026-04-29.
Decision dates by country: ES: 2025-04-07, FR: 2025-04-04, IT: 2026-04-29

Condition(s): Solid Tumors

Source: https://euclinicaltrials.eu/ctis-public/view/2024-519445-29-00